EU clinical trial 2024-515944-22-00: IFCT-1904 ENCO-BRAF A Phase II study of the BRAF inhibitor Encorafenib in combination with the MEK inhibitor Binimetinib in Patients with BRAFV600E-mutant metastatic Non-small Cell Lung Cancer
Protocol code: IFCT-1904
Sponsor: Intergroupe Francophone De Cancerologie Thoracique (Patient organisation/association). Phase: Therapeutic exploratory (Phase II). Countries: France (ongoing, recruitment ended).
Therapeutic area(s): Diseases [C] - Neoplasms [C04]
Gender: Female, Male. Age: 18-64 years, 65+ years. Enrolment: 119.
Status: Ongoing, recruitment ended. Start date (EU): 2021-01-19. Decision date: 2024-10-31. Results received: No. Last updated: 2024-10-31.

Condition(s): BRAFV600E-mutant metastatic Non-small Cell Lung Cancer
Product: Braftovi 75 mg hard capsules, Mektovi 15 mg film-coated tablets

Primary endpoint: ORR, which is defined as the percentage of subjects with a confirmed complete response (CR) or partial response (PR) by investigator assessment as per RECIST v1.1 criteria. Each cohort will be analysed separately.
Endpoint(s): DOR (Duration Response Rate) defined as the time from the date of the first documented response (CR or PR) to the earliest date of disease progression, as determined by Investigator review and by independent reviewer of radiographic disease assessments per RECIST v1.1, or death due to any cause., DCR (Disease Control Rate) defined as the proportion of patients having achieved a confirmed best overall response of CR, PR or SD, as determined by Investigator review and by independent reviewer of radiographic disease assessments per RECIST v1.1., PFS (Progression Free Survival) defined as the time from the date of inclusion to the earliest date of disease progression, as determined by Investigator review and by independent reviewer of radiographic disease assessments per RECIST v1.1, or death due to any cause., ORR, which is defined as the percentage of subjects with a confirmed complete response (CR) or partial response (PR) by independent reviewer as per RECIST v1.1 criteria., TTP (Time To Tumour Progression) defined as the time from the date of inclusion to the earliest date of disease progression, as determined by Investigator review and by independent reviewer of radiographic disease assessments per RECIST v1.1., PFS L2 defined as the time between the start date of the second line and the first of documented progression after the start L2, as determined by Investigator review of radiographic disease assessments per RECIST v1.1, or death due to any cause., OS (Overall Survival) defined as the time from the date of first dose of study drug to the date of death due to any cause, Incidence and severity of AEs graded according to the NCI CTCAE version 4.03 and changes in clinical laboratory parameters, vital signs, ECGs and ECHO/MUGA scans., Change from baseline of EuroQol Quality of Life 5-Dimension 5-Level Scale (EQ-5D-5L) at all scheduled time points.

Source: https://euclinicaltrials.eu/ctis-public/view/2024-515944-22-00